EU clinical trial 2024-516112-21-00: Myechild 01: International Randomised Phase III Clinical Trial in Children with Acute Myeloid Leukaemia - Incorporating an Embedded Dose Finding Study for Gemtuzumab Ozogamicin in Combination with Induction Chemotherapy
Protocol code: RG_14-088
Sponsor: The University Of Birmingham (Educational Institution). Phase: Therapeutic confirmatory (Phase III). Countries: Ireland (ongoing, recruitment ended), France (ongoing, recruitment ended).
Therapeutic area(s): Diseases [C] - Neoplasms [C04]
Gender: Female, Male. Age: 0-17 years. Enrolment: 289.
Status: Ongoing, recruitment ended. Start date (EU): 2017-11-20. Decision date: 2024-12-02. Results received: No. Last updated: 2024-12-02.
Decision dates by country: FR: 2024-12-02, IE: 2024-12-02

Condition(s): Newly diagnosed acute myeloid leukaemia (AML), high risk myelodysplastic syndrome (MDS) and isolated myeloid sarcoma (either de novo or secondary)
Product: CYCLOPHOSPHAMIDE, CYTARABINE, CYTARABINE, FLUDARABINE PHOSPHATE, BUSULFAN, CYCLOPHOSPHAMIDE, FLUDARABINE PHOSPHATE, CYTARABINE, MITOXANTRONE, CYCLOPHOSPHAMIDE, CYTARABINE, MYLOTARG 5 mg powder for concentrate for solution for infusion

Primary endpoint: Dose Finding Study: The incidence of dose limiting toxicities (DLTs), R1: Event-free survival (EFS) from date of randomisation 1 (R1), R2: Event-free survival (EFS) from date of randomisation 2 (R2), R3: Relapse-free survival (RFS) from date of randomisation 3 (R3), R4: Early treatment related adverse reactions defined as the incidence by day 100 post-transplant of grade 3-5 toxicity for specific toxicities in the following systems using the National Cancer Institute (NCI) Common Terminology Criteria v4: Cardiac; Respiratory, thoracic and mediastinal; Gastrointestinal; Investigations; Renal and Urinary; Nervous system, R4: Relapse-free survival (RFS) from date of randomisation 4 (R4)
Endpoint(s): Dose Finding Study: The nature, incidence and severity of AEs evaluated until day 45 post course 1 and course 2, Dose Finding Study: Response measured by bone marrow morphology and MRD assessment post course 1 and 2, Complete Remission (CR) defined as CR or CRi and evaluated post course 1 and 2 of treatment (R1 and R2 only), Reasons for failure to achieve CR evaluated pose course 1 and 2 of treatment and classified as resistant disease, induction death or not evaluable (R1 and R2 only), Cumulative incidence of relapse (CIR) defined as time from first CR or CRi for patients entering at induction or from randomisation to the relevant question for patients entering at R3 or R4, to relapse, Death in CR (DCR) defined as time from first CR or CRi for patients entering at induction or from randomisation to the relevant question for patients entering at R3 or R4, to date of death from any cause., Event-free survival defined as time from randomisation to the relevant question to the first of failure to achieve CR (recorded as an event on day 1), relapse, secondary malignancy or death from any cause., Overall Survival (OS) defined as time from randomisation to the relevant question to death from any cause or date last seen for patients who are alive at the end of the trial, Incidence of cardiotoxicity experienced within 10 years of randomisation and defined as a fall in fractional shortening to <28% or ejection fraction <55% (R1, R2 and R4 only), Incidence of bilirubin of grade 3 or higher experienced within 30 days of end of trial treatment (R2 and R4 only), Incidence of veno-occlusive disease experienced within 30 days of end of trial treatment (R2 and R4 only), MRD negativity post course 1, course 2 and at the end of treatment (R1 and R2 only), Time to haematological recovery defined as time from start of course to date of neutrophil recovery to 1.0 x 10^9/L and platelet recovery to 80 x 10^9/L for DFS patients; and neutrophil recover to 0.75 x 10^9/L and platelet recovery to 75 x 10^9/L for all other patients, Days in hospital per course of treatment, Incidence of mixed chimerism at day 100 post-transplant (R4 only), Treatment Related Mortality (TRM) defined as the time bwtween randomisation to R4 and death which is unrelated to the underlying disease and considered related to the transplant procedure (R4 only), Gonadal function at 1 year post-transplant and end of study follow up, assessed by Tanner stage, gonadotrophins and serum AMH (females)/inhibin B (males) (R4 only)

Source: https://euclinicaltrials.eu/ctis-public/view/2024-516112-21-00